EU clinical trial 2024-519310-31-00: Efficacy and Safety of Luspatercept for the Treatment of Anemia Due to Myelodysplastic Syndromes with del5q refractory/resistant/intolerant to Prior Treatments, Who Require Red Blood Cell Transfusion.
Protocol code: QOL-ONE Phoenix
Sponsor: Associazione Qol-One (Patient organisation/association). Phase: Therapeutic exploratory (Phase II). Countries: Italy (ongoing, recruiting).
Therapeutic area(s): Diseases [C] - Hemic and Lymphatic Diseases [C15]
Gender: Female, Male. Age: 18-64 years, 65+ years. Enrolment: 22.
Status: Ongoing, recruiting. Start date (EU): 2025-01-27. Decision date: 2025-01-27. Results received: No. Last updated: 2025-11-28.

Condition(s): Anemia due to MDS with del5q with IPSS-R very low, low, or intermediate risk MDS and abone marrow blast count of < 5% , Refractory or intolerant to, or ineligible for, prior ESA treatment and for prior lenalidomide treatment and who require RBC transfusions.
Product: Reblozyl 25 mg powder for solution for injection, Reblozyl 75 mg powder for solution for injection

Primary endpoint: RBC Transfusion Independence (for 8 weeks in the first 24 weeks)
Endpoint(s): Safety and tolerability of Luspatercept, RBC-TI at 48 weeks and end of the study, Duration of RBC-TI, Reduction in RBC transfusions, Increase in hemoglobin, Change in quality of life scores (ie. QOL-E and HM-PRO), Change in Serum Ferritin, Change in iron chelation therapy use, Time to RBC TI

Source: https://euclinicaltrials.eu/ctis-public/view/2024-519310-31-00